EU clinical trial 2025-520653-37-00: Application of the autologous CAR T cells (Tarcidomgen Kimleucel) in the treatment of refractory and relapsed CD19+ B cell neoplasms
Protocol code: CARLA
Sponsor: Famicordtx S.A., Polski Bank Komorek Macierzystych Sp. z o.o. (Pharmaceutical company). Phase: Human Pharmacology (Phase I)- First administration to humans. Countries: Poland (ongoing, recruiting).
Therapeutic area(s): Diseases [C] - Hemic and Lymphatic Diseases [C15]
Gender: Female, Male. Age: 18-64 years. Enrolment: 6.
Status: Ongoing, recruiting. Start date (EU): 2025-01-30. Decision date: 2025-01-30. Results received: No. Last updated: 2025-01-30.

Condition(s): Application of the autologous CAR T cells (Tarcidomgen Kimleucel) in the treatment of refractory and relapsed CD19+ B cell neoplasms

Source: https://euclinicaltrials.eu/ctis-public/view/2025-520653-37-00